EU clinical trial 2023-507059-32-00: A study to assess the safety, tolerability, uptake and efficacy of VMX-C001 in healthy volunteers.
Protocol code: VMX-C001-03
Sponsor: VarmX B.V. (Pharmaceutical company). Phase: Human Pharmacology (Phase I)- Other. Countries: Netherlands (ongoing, recruitment ended).
Therapeutic area(s): Diseases [C] - Hemic and Lymphatic Diseases [C15]
Gender: Female, Male. Age: 18-64 years, 65+ years. Enrolment: 48.
Status: Ongoing, recruitment ended. Start date (EU): 2024-02-21. Decision date: 2023-11-17. Results received: No. Last updated: 2026-05-18.

Condition(s): To restore coagulation in patients taking DOACs who are experiencing bleeding or who require reversal of anticoagulation prior to urgent surgery.

Source: https://euclinicaltrials.eu/ctis-public/view/2023-507059-32-00